EU clinical trial 2025-521768-36-00: A Phase I/II, randomized, multi-site trial to investigate the efficacy and safety of BNT314 in combination with pumitamig and chemotherapy in participants with metastatic colorectal cancer
Protocol code: BNT314-02
Sponsor: BioNTech SE (Pharmaceutical company). Phase: Phase I and Phase II (Integrated)- Other. Countries: Spain (ongoing, recruiting), Germany (ongoing, recruiting).
Therapeutic area(s): Diseases [C] - Neoplasms [C04]
Gender: Female, Male. Age: 18-64 years, 65+ years. Enrolment: 168.
Status: Ongoing, recruiting. Start date (EU): 2026-01-27. Decision date: 2025-10-20. Results received: No. Last updated: 2026-06-09.
Decision dates by country: ES: 2025-10-20, DE: 2025-10-22

Condition(s): Metastatic colorectal cancer
Product: BNT327, BNT314, BNT327 1-15

Primary endpoint: Phase I - Safety run-in (Part A): Occurrence of dose limiting toxicities (DLTs) during the DLT observation period, Phase I - Safety run-in (Part A): Occurrence of treatment emergent adverse events (TEAEs) and treatment related adverse events (TRAEs) assessed according to Common Terminology Criteria for Adverse Events (CTCAE), Phase I - Safety run-in (Part A): Occurrence of dose interruption or discontinuation of trial treatment due to TEAEs, Phase I - Dose optimization (Part B): Occurrence of DLTs during the DLT observation period for the first five participants in each dose cohort, Phase I - Dose optimization (Part B): Occurrence of TEAEs and TRAEs assessed according to CTCAE v5.0 including Grade ≥3, serious, fatal TEAEs by relationship, Phase I - Dose optimization (Part B): Occurrence of dose interruption or discontinuation of trial treatment due to TEAEs, Phase I - Dose optimization (Part B): Objective response rate (ORR) is defined as the percentage of participants in whom a complete response (CR) or confirmed partial response (PR) is observed as best overall response., Pivotal Phase II (Part C): Progression free survival (PFS) is defined as the time from randomization to first documented tumor progression, or death from any cause, whichever occurs first.
Endpoint(s): Phase I - Safety run-in (Part A) and Pivotal Phase II (C): ORR is defined as the proportion of participants in whom a confirmed CR or PR is observed as best overall response, All Phases: Duration of response (DOR) is defined as the time from first objective response to first occurrence of objective tumor progression or death from any cause, whichever occurs first., Phase I - Safety run-in (Part A) and Dose optimization (Part B): Disease control rate (DCR) is defined as the proportion of participants with confirmed CR or PR or stable disease (SD) observed as best ORR per BICR., Phase I - Safety run-in (Part A) and Dose Optimization (Part B): Pharmacokinetic (PK) concentration over time and PK parameters of BNT314 and pumitamig in serum, as data permits., Phase I - Safety run-in (Part A) and Dose optimization (Part B): Anti-drug antibody (ADA) prevalence for up to 1 year from the last dose of IMP, by dose level., Phase I - Safety run-in (Part A) and Dose optimization (Part B): ADA incidence for up to 1 year from the last dose of IMP, by dose level., Pivotal Phase II (Part C): Overall survival (OS) defined as the time from randomization to death from any cause, Pivotal Phase II (Part C): Occurrence of TEAEs and TRAEs assessed according to Common Terminology Criteria for Adverse Events (CTCAE) v5.0 including Grade ≥3, serious, fatal TEAEs by relationship, Pivotal Phase II (Part C): Occurrence of dose interruption or discontinuation of study treatment due to TEAEs

Source: https://euclinicaltrials.eu/ctis-public/view/2025-521768-36-00